EU clinical trial 2023-503208-94-00: A Phase IV, Post-Authorization Safety Study to Investigate the Long-Term Safety of lutetium (177Lu) vipivotide tetraxetan in Adult Participants with Prostate Cancer
Protocol code: CAAA617A12402
Sponsor: Novartis Pharma AG (Pharmaceutical company). Phase: Therapeutic use (Phase IV). Countries: Czechia (authorised, recruitment pending), Poland (authorised, recruitment pending), Sweden (ongoing, recruiting), Spain (ongoing, recruiting), Netherlands (ongoing, recruiting), Germany (ongoing, recruiting), Belgium (ongoing, recruiting), Austria (authorised, recruitment pending), France (ongoing, recruiting), Italy (authorised, recruitment pending).
Therapeutic area(s): Diseases [C] - Neoplasms [C04]
Gender: Male. Age: 18-64 years, 65+ years. Enrolment: 300.
Start date (EU): 2024-04-04. Decision date: 2023-11-27. Results received: No. Last updated: 2026-06-08.
Decision dates by country: DE: 2023-11-30, NL: 2023-11-29, AT: 2023-11-28, CZ: 2023-11-28, SE: 2023-11-29, PL: 2023-11-27, FR: 2023-11-28, ES: 2023-11-28, BE: 2023-11-28, IT: 2026-06-08

Condition(s): Prostate cancer
Product: Pluvicto 1 000 MBq/mL solution for injection/infusion

Primary endpoint: Number and proportion of participants with selected AEs and serious adverse events (SAEs), changes in laboratory values
Endpoint(s): Number and proportion of participants who have died, Potential correlation between absorbed radiation dose in kidney or other selected organs and safety of AAA617 (if sufficient amount of dosimetry data is available from the parent treatment study)

Source: https://euclinicaltrials.eu/ctis-public/view/2023-503208-94-00